EU clinical trial 2024-513900-32-00: Phase 1/2 Master Protocol for Open-Label, Multi-Centre, Single-Arm Sub-Studies, First in Human Clinical Studies of TCR-T Therapy (Autologous TCR-Modified T-Cell Therapy) Targeting Mutated Kirsten Rat Sarcoma (mutKRAS) Administered in Metastatic or Locally Advanced Pancreatic Ductal Adenocarcinoma (PDAC) Adult Patients with Specific mutKRAS and Human Leukocyte Antigen (HLA) Genotypes
Protocol code: CTP-ANOC-IS-001
Sponsor: Anocca AB (Pharmaceutical company). Phase: Phase I and Phase II (Integrated)- First administration to humans. Countries: Germany (ongoing, recruiting), Denmark (ongoing, recruiting), Netherlands (ongoing, recruiting), Sweden (ongoing, recruiting).
Therapeutic area(s): Diseases [C] - Neoplasms [C04]
Gender: Female, Male. Age: 18-64 years, 65+ years. Enrolment: 57.
Status: Ongoing, recruiting. Start date (EU): 2025-07-03. Decision date: 2025-03-04. Results received: No. Last updated: 2026-04-02.
Decision dates by country: SE: 2025-03-05, NL: 2025-03-10, DE: 2025-03-05, DK: 2025-03-04

Condition(s): Pancreatic Ductal Adenocarcinoma

Primary endpoint: Phase 1 Safety and tolerability: Incidence and nature of DLTs of ANOC- 001, ANOC-002 and ANOC-003, graded according to American Society of Transplantation and Cellular Therapy (ASTCT) consensus criteria., Phase 1 Safety and tolerability: Incidence, nature, and severity of adverse events (AEs) graded according to National Cancer Institute Common Terminology Criteria for AEs (NCI- CTCAE) v5.0., Phase 1 Safety and tolerability: Identification of the MTD/MAD or RP2D of ANOC-001, ANOC-002 and ANOC- 003 that can be administered safely in participants with metastatic and locally advanced PDAC., Phase 2 Safety and tolerability: Incidence, nature, and severity of adverse events of special interest (AESIs) according to NCI-CTCAE v5.0
Endpoint(s): Phase 1 and Phase 2 Feasibility: Percentage of participants who receive planned target dose of ANOC-001, ANOC-002 or ANOC-003, Phase 1 and Phase 2 Expansion/persistence: Maximum persistence of TCR T cells as peak cell expansion at different time intervals to detect infused cells., Phase 1 and Phase 2 Efficacy: Objective Response Rate (ORR) as defined as the percentage of participants with a Best Overall Response (BOR) of Complete Response (CR) or Partial Response (PR) per RECIST v1.1. participants., Phase 1 and Phase 2 Efficacy: CBR defined as percentage of participants with SD more than 3 months, or PR/CR from the time of study treatment., Phase 1 and Phase 2 Efficacy: Progression-free survival (PFS), defined as the time from study treatment to the first occurrence of disease progression or death, whichever occurs first., Phase 1 and Phase 2 Efficacy: Overall survival (OS) defined as the time from study treatment to death from any cause., Phase 1 and Phase 2 Efficacy: Duration of response (DoR) defined as the time from the first documentation of a tumour response (PR/CR) to disease progression or death in participants who achieve CR or PR., Phase 1 and Phase 2 Feasibility: Feasibility of manufacture of ANOC-001, ANOC-002 and ANOC-003 including the percentage of the manufactured IMPs that comply with the specifications as compared to the total number of the IMP manufactured.

Source: https://euclinicaltrials.eu/ctis-public/view/2024-513900-32-00